EU clinical trial 2022-502717-28-00: A single arm study investigating the glycaemic control and safety of adding semaglutide to insulin icodec in participants with type 2 diabetes qualifying for treatment intensification.
Protocol code: NN1436-4910
Sponsor: Novo Nordisk A/S (Pharmaceutical company). Phase: Therapeutic confirmatory (Phase III). Countries: Poland (ended), Czechia (ended).
Therapeutic area(s): Diseases [C] - Nutritional and Metabolic Diseases [C18]
Gender: Female, Male. Age: 18-64 years, 65+ years. Enrolment: 70.
Status: Ended. Start date (EU): 2024-01-09. End date (EU): 2025-05-23. End date: 2025-05-24. Decision date: 2023-08-31. Results received: Yes. Last updated: 2025-05-23.
Decision dates by country: PL: 2023-09-01, CZ: 2023-08-31

Condition(s): Diabetes Type 2
Product: insulin icodec 700 U/mL PDS290, Semaglutide B 1.34 mg/ml PDS290

Primary endpoint: Change in glycated haemoglobin (HbA1c), Change in mean 7-point SMPG profiles, Change in mean post‑prandial glucose increment (over all meals), Change in fasting plasma glucose (FPG)
Endpoint(s): Number of severe hypoglycaemic episodes (level 3), Number of clinically significant hypoglycaemic episodes (level 2) (<3.0 mmol/L (54 milligrams Per Deciliter (mg/dL)), confirmed by blood glucose (BG) meter), Number of clinically significant hypoglycaemic episodes (level 2) (<3.0 mmol/L (54 mg/dL), confirmed by BG meter) or severe hypoglycaemic episodes (level 3), Change in body weight, Relative change in weekly insulin icodec dose

Source: https://euclinicaltrials.eu/ctis-public/view/2022-502717-28-00